EU clinical trial 2024-511877-31-00: Long-term pain modulation by intravenous esketamine in Complex Regional Pain Syndrome: a non-inferiority study
Protocol code: NL77785.078.21
Sponsor: Erasmus Universitair Medisch Centrum Rotterdam (Erasmus MC) (Hospital/Clinic/Other health care facility). Phase: Therapeutic use (Phase IV). Countries: Netherlands (ongoing, recruitment ended).
Therapeutic area(s): Diseases [C] - Musculoskeletal Diseases [C05]
Gender: Female, Male. Age: 18-64 years, 65+ years. Enrolment: 60.
Status: Ongoing, recruitment ended. Start date (EU): 2024-04-22. Decision date: 2024-04-22. Results received: No. Last updated: 2024-04-22.

Condition(s): Complex regional pain syndrome
Product: Ketanest® S 25 mg/ml - Ampullen, Ketanest® S 5 mg/ml - Ampullen

Primary endpoint: Pain intensity measured by Numerical Rating Scale (NRS). The current NRS score reflecting the pain intensity at the moment when asked and the average NRS score of the last 24 hours. (T0, T3, T4)
Endpoint(s): To assess protocol deviations due to logistical problems for each of the administration regimens: premature termination (due to i.e. bed capacity problems), waiting time for therapy (weeks) and compliance of the patients. (T1, T2), Number and severity of intervention related adverse events: Psychomimetic (dysphoria, euphoria, hallucinations, nightmares and vivid dreams, anxiety, agitation), blurry vision or diplopia, nausea and / or vomiting, sedation, hepatic toxicity, headache and dislocation of peripheral intravenous catheter (T1, T2), Number of administered co-interventions related to adverse events (benzodiazepines, clonidine, granisetron). (T1), NRS pain scores over time till follow-up T3. The current NRS score reflecting the pain intensity at the moment when asked by telephone and the average NRS score of the last 24 hours. (T1, T2), Objectively measured effects of each of the administration regimens on the inflammation; serum levels of sIL-2R and sCD163 will be detected with Enzyme Linked Immunosorbent Assay (ELISA) as measures for T-lymphocyte and macrophage activation, respectively. In addition, T cell populations and monocyte populations will be identified using flow cytometry. (T0, T3), To assess the sensory-discriminative dimensions of pain before and after ketamine treatment; Quantitative Sensory Testing (T0, T3), Objectively measured effects of each of the administration regimens on symptoms vasomotor disturbances; Thermography (T0, T3), Dose reduction of pain medication at follow after three months and six months (T3, T4), CRPS symptoms and signs based on the Budapest diagnostic clinical criteria; CRPS severity score (20). (T0, T3), Questionnaires COMPACT (Core Outcome Measurement set for complex regional PAin syndrome Clinical sTudies) (42, 43):

Source: https://euclinicaltrials.eu/ctis-public/view/2024-511877-31-00